EU clinical trial 2023-508819-23-00: Study to assess the safety, pharmacokinetics and efficacy of HMPL-523 in patients with Immune Thrombocytopenia
Protocol code: 2022-523-GLOB1
Sponsor: Hutchmed Ltd. (Pharmaceutical company). Phase: Human Pharmacology (Phase I)- Other. Countries: Norway (ended), Spain (ended), Germany (ended).
Therapeutic area(s): Diseases [C] - Hemic and Lymphatic Diseases [C15]
Gender: Female, Male. Age: 18-64 years, 65+ years. Enrolment: 22.
Status: Ended. Start date (EU): 2024-07-24. End date (EU): 2025-05-19. End date: 2025-05-19. Decision date: 2024-06-05. Results received: No. Last updated: 2025-01-30.
Decision dates by country: ES: 2024-06-06, DE: 2024-08-30, NO: 2024-06-05

Condition(s): Primary immune thrombocytopenia (ITP)

Source: https://euclinicaltrials.eu/ctis-public/view/2023-508819-23-00